EU clinical trial 2025-524822-16-00: Prevention of chronic headache with anti-CGRP antibody treatment in patients with idiopathic intracranial hypertension
Sponsor: Rigshospitalet (Hospital/Clinic/Other health care facility). Phase: Therapeutic confirmatory (Phase III). Countries: Denmark (ongoing, recruiting).
Therapeutic area(s): Diseases [C] - Nervous System Diseases [C10]
Gender: Female. Age: 18-64 years. Enrolment: 96.
Status: Ongoing, recruiting. Start date (EU): 2026-06-24. Decision date: 2026-04-13. Results received: No. Last updated: 2026-04-13.

Condition(s): Idiopathic intracranial hypertension

Source: https://euclinicaltrials.eu/ctis-public/view/2025-524822-16-00